EU clinical trial 2024-513950-32-00: IMMUWIN - A Phase II study of immunotherapy with durvalumab (MEDI4736) and tremelimumab in combination with Y-90 SIRT for intermediate stage HCC
Protocol code: IMMUWIN
Sponsor: Frankfurter Institut Fuer Klinische Krebsforschung IKF GmbH (Pharmaceutical company). Phase: Therapeutic exploratory (Phase II). Countries: Germany (ongoing, recruitment ended).
Therapeutic area(s): Diseases [C] - Neoplasms [C04]
Gender: Female, Male. Age: 18-64 years, 65+ years. Enrolment: 55.
Status: Ongoing, recruitment ended. Start date (EU): 2020-12-15. Decision date: 2024-09-03. Results received: No. Last updated: 2026-02-06.

Condition(s): Intermediate stage hepatocellular carcinoma (HCC)
Product: IMFINZI 50 mg/mL concentrate for solution for infusion., TREMELIMUMAB

Primary endpoint: Objective response rate (ORR) [according to RECIST 1.1] after 6 months.
Endpoint(s): PFS, OS, Safety (AEs, impact of liver function, use of subsequent therapies), ORR as BOR during therapy, ORR within 6 months for patients who received single treatment of TACE/SIRT, ORR within 6 months for patients who received additional treatment of TACE/SIRT, QoL

Source: https://euclinicaltrials.eu/ctis-public/view/2024-513950-32-00